EU clinical trial 2024-516750-21-00: A phase I/II trial of Obinutuzumab, ABT-199 (GDC-0199) plus Ibrutinib in Relapsed / Refractory Mantle Cell Lymphoma patients (OAsIs)
Protocol code: RC14_0048
Sponsor: Centre Hospitalier Universitaire De Nantes (Hospital/Clinic/Other health care facility). Phase: Phase I and Phase II (Integrated)- Other. Countries: France (ended).
Therapeutic area(s): Diseases [C] - Neoplasms [C04]
Gender: Female, Male. Age: 18-64 years, 65+ years. Enrolment: 44.
Status: Ended. Start date (EU): 2015-10-14. End date (EU): 2025-05-13. Decision date: 2024-10-18. Results received: No. Last updated: 2025-04-02.

Condition(s): Patients with relapsed / refractory Mantle Cell Lymphoma
Product: Ibrutinib, OBINUTUZUMAB, GDC-0199

Primary endpoint: Step A : The occurrence of unacceptable toxicity (definition p35) of the combination of GA101 and Ibrutinib during the first cycle of treatment. Step B : The occurrence of unacceptable toxicity (definition p35) of the combination of GA101 and Ibrutinib plus GDC-0199 during the cycle 2 in terms of Dose-Limiting Toxicities (DLTs). Step C : The occurrence of unacceptable toxicity of the combination of GA101 and Ibrutinib plus GDC-199 at the end of the cycle 2
Endpoint(s): • Safety (type, frequency, severity, and relationship of adverse events to study treatment), • Incidence of Serious Adverse Event (SAE), Adverse Event (AE) and laboratory abnormalities., • Incidence and severity of tumor lysis syndrome, • Time to progression and overall survival, • Response (CR, PR, SD, PD) and overall response (CR+ PR) rates

Source: https://euclinicaltrials.eu/ctis-public/view/2024-516750-21-00